EU clinical trial 2025-522145-21-00: Studying Treatments in patients receiving androgen deprivation therapy (ADT) for Metastatic Prostate Cancer: Evaluation of Drug and radiation Efficacy: A 2nd multi-arm multi-stage randomised controlled trial (STAMPEDE2)
Protocol code: PR12
Sponsor: University College London (Educational Institution). Phase: Therapeutic confirmatory (Phase III). Countries: Ireland (authorised, recruitment pending), Germany (authorised, recruitment pending), Spain (ongoing, recruiting).
Therapeutic area(s): Diseases [C] - Neoplasms [C04]; Diseases [C] - Male Urogenital Diseases [C12]
Gender: Male. Age: 18-64 years, 65+ years. Enrolment: 346.
Start date (EU): 2026-04-13. Decision date: 2026-02-25. Results received: No. Last updated: 2026-07-14.
Decision dates by country: DE: 2026-02-25, ES: 2026-03-04, IE: 2026-03-06

Condition(s): Metastatic hormone sensitive prostate cancer
Product: Pluvicto 1 000 MBq/mL solution for injection/infusion

Primary endpoint: For both Comparisons S and P, the primary outcome is Overall Survival (OS) defined as time from randomisation to death from any cause.
Endpoint(s): Failure-Free Survival (FFS), Radiographic Progression-Free-Survival (rPFS), Prostate cancer specific survival (PCSS), Safety, toxicity and compliance, Quality of life, Cost and resources.

Source: https://euclinicaltrials.eu/ctis-public/view/2025-522145-21-00